EU clinical trial 2024-510626-89-00: A Phase 3, Multinational, Double-Blind, Randomized, Placebo-Controlled Study of MGL-3196 (resmetirom) in Patients With Non-Alcoholic Steatohepatitis (NASH) and Fibrosis to Resolve NASH and Reduce Progression to Cirrhosis and/or Hepatic Decompensation
Protocol code: MGL-3196-11
Sponsor: Madrigal Pharmaceuticals Inc. (Pharmaceutical company). Phase: Therapeutic confirmatory (Phase III). Countries: Poland (ongoing, recruitment ended), Belgium (ongoing, recruitment ended), Austria (ongoing, recruitment ended), Hungary (ongoing, recruitment ended), Italy (ongoing, recruitment ended), France (ongoing, recruitment ended), Germany (ongoing, recruitment ended), Spain (ongoing, recruitment ended).
Therapeutic area(s): Diseases [C] - Digestive System Diseases [C06]
Gender: Female, Male. Age: 18-64 years, 65+ years. Enrolment: 444.
Status: Ongoing, recruitment ended. Start date (EU): 2019-11-18. Decision date: 2024-04-22. Results received: No. Last updated: 2026-06-23.
Decision dates by country: FR: 2024-05-06, AT: 2024-04-26, BE: 2024-04-26, DE: 2024-05-08, HU: 2024-04-24, IT: 2024-05-03, ES: 2024-04-22, PL: 2024-04-24

Condition(s): Non-Alcoholic Steatohepatitis (NASH)
Product: Matching placebo MGL-3196 60 mg film-coated tablet, Matching placebo MGL-3196 80 mg film-coated tablet, Matching placebo MGL-3196 100 mg film-coated tablet., MGL-3196 80 mg oral, MGL-3196 60 mg oral, MGL-3196 100 mg oral

Primary endpoint: Week 52 Dual Primary endpoints: NASH Resolution Response at Week 52 Fibrosis ≥ 1 Stage Responder at Week 52, Time to Composite Clinical Outcome Event at Month 54
Endpoint(s): Percent change from baseline in directly measured LDL-C at Week 24 and Week 52

Source: https://euclinicaltrials.eu/ctis-public/view/2024-510626-89-00